EU clinical trial 2023-509483-20-00: Investigating how CagriSema, semaglutide and cagrilintide regulate insulin effects in the body of people with type 2 diabetes.
Protocol code: NN9388-7782
Sponsor: Novo Nordisk A/S (Pharmaceutical company). Phase: Human Pharmacology (Phase I)- Other. Countries: Germany (ended).
Therapeutic area(s): Diseases [C] - Nutritional and Metabolic Diseases [C18]
Gender: Female, Male. Age: 18-64 years, 65+ years. Enrolment: 150.
Status: Ended. Start date (EU): 2024-04-26. End date (EU): 2026-02-02. Decision date: 2024-04-03. Results received: No. Last updated: 2026-01-30.
Decision dates by country: DE: 2024-05-24

Condition(s): Type 2 diabetes

Source: https://euclinicaltrials.eu/ctis-public/view/2023-509483-20-00